EU clinical trial 2024-517121-10-00: C4951063: An interventional efficacy and safety, Phase 3, double-blind, parallel group study to investigate intermittent prevention of Menstrual Migraine with Rimegepant compared with placebo in women participants 18 to 45 years of age
Protocol code: C4951063
Sponsor: Pfizer Inc. (Pharmaceutical company). Phase: Therapeutic confirmatory (Phase III). Countries: Netherlands (ongoing, recruitment ended), Italy (ongoing, recruitment ended), Poland (ongoing, recruitment ended), Denmark (ongoing, recruitment ended), Germany (ongoing, recruitment ended), Spain (ongoing, recruitment ended).
Therapeutic area(s): Diseases [C] - Nervous System Diseases [C10]
Gender: Female. Age: 18-64 years. Enrolment: 96.
Status: Ongoing, recruitment ended. Start date (EU): 2025-10-17. Decision date: 2025-10-06. Results received: No. Last updated: 2026-07-08.
Decision dates by country: NL: 2025-10-07, ES: 2025-10-10, PL: 2025-10-10, DK: 2025-10-06, IT: 2025-10-10, DE: 2025-10-16

Condition(s): Menstrual Migraine
Product: VYDURA 75 mg oral lyophilisate, matching placebo for 75 mg oral lyophilisate

Primary endpoint: Mean change from the OP in number of migraine days per 5-day PMP across each cycle of the DBT Phase.
Endpoint(s): Mean change from the OP in number of headache days per 5-day PMP across each cycle of the DBT Phase., Percentage of participants with ≥50% reduction from the OP in number of migraine days per 5-day PMP across each cycle of the DBT Phase (50% responder)., Mean change from the OP in number of acute migraine medication days per 5-day PMP across each cycle of the DBT Phase., Mean change from the OP in number of acute migraine-specific medication days per 5-day PMP across each cycle of the DBT Phase (based on eDiary response)., Mean change from the OP in number of migraine days with moderate-severe functional disability per 5-day PMP across each cycle of the DBT Phase., Mean change from the OP in number of moderate-severe headache days per 5-day PMP across each cycle of the DBT Phase., Mean change from the OP in number of moderate-severe migraine days per 5-day PMP across each cycle of the DBT Phase., Mean change from baseline in the MiCOAS (Migraine Clinical Outcome Assessment System) Cognition score at post-dosing (ie, 1 day after the 7-day dosing period) across each cycle of the DBT Phase., Mean change from the OP in monthly migraine days (per cycle, normalized to 28-days) across each cycle of the DBT Phase., Mean change from the OP in monthly headache days (per cycle, normalized to 28-days) across each cycle of the DBT Phase., Mean change from the OP in monthly acute migraine-specific medication days (per cycle, normalized to 28-days) across each cycle of the DBT Phase.

Source: https://euclinicaltrials.eu/ctis-public/view/2024-517121-10-00